EU clinical trial 2023-507518-28-00: A Randomized, Placebo‐Controlled Phase III Study of Induction and Consolidation Chemotherapy With Venetoclax in Adult Patients With Newly Diagnosed Acute Myeloid Leukemia or Myelodysplastic Syndrome With Excess Blasts‐2
Protocol code: AMLSG31-19
Sponsor: Universitaetsklinikum Ulm AöR (Hospital/Clinic/Other health care facility). Phase: Therapeutic confirmatory (Phase III). Countries: Germany (ongoing, recruiting), Austria (authorised, recruiting), Belgium (ongoing, recruiting), Estonia (authorised, recruiting), Finland (authorised, recruitment pending), Lithuania (authorised, recruitment pending), Netherlands (ongoing, recruiting), Norway (ongoing, recruiting).
Therapeutic area(s): Diseases [C] - Hemic and Lymphatic Diseases [C15]
Gender: Female, Male. Age: 18-64 years, 65+ years. Enrolment: 423.
Start date (EU): 2022-09-13. Decision date: 2023-12-21. Results received: No. Last updated: 2026-07-21.
Decision dates by country: EE: 2025-01-24, LT: 2025-01-17, BE: 2025-01-14, FI: 2025-01-31, NL: 2025-01-30, AT: 2025-01-31, DE: 2023-12-21, NO: 2025-01-28

Condition(s): Acute myeloid leukemia
Product: Venetoclax, CYTARABINE, Venetoclax, DAUNORUBICIN, Venetoclax

Primary endpoint: EFS in adult patients with newly diagnosed AML, defined as the time from randomization to treatment failure, death from any cause, relapse after achieving CR or CRi, or start of new (non-study) therapy due to confirmed molecular progression or relapse whichever occurs first. Treatment failure is defined as not attaining CR or CRi by induction chemotherapy, and EFS event time for treatment failure is date of randomization.
Endpoint(s): Overall survival (OS) in newly diagnosed AML patients, defined as the time from randomization to death due to any cause. Patients still alive or lost to follow up will be censored at the time they were last known to be alive., Rate of complete remission (CR) or CR with incomplete blood count recovery (CRi) rate in newly diagnosed AML patients defined as the proportion of AML patients with CR/CRi by the end of induction chemotherapy., Complete remission (CR) rates in newly diagnosed AML patients defined as the proportion of AML patients with CR by the end of induction chemotherapy., Rates of CR CR/CRh, and CR/CRi without measurable residual disease (CRMRD-, CR/CRhMRD-, CR/CRiMRD-) by the end of induction therapy, defined as the proportion of AML patients achieving CR, CR/CRh and CR/CRi with negativity for a genetic marker by RT-qPCR, and/or with negativity by multi-parameter flow cytometry, if studied pre-treatment., Relapse-free survival (RFS) in newly diagnosed AML patients, defined as the time from achievement of a remission (CR/CRh/CRi) following induction therapy, to morphologic relapse, start of new (non-study) therapy due to confirmed molecular progression or relapse or death from any cause. Patients who are not known to have relapsed, died or started new therapy due to confirmed molecular progression or relapse will be censored at the date of last clinical response assessment., Cumulative incidence of relapse (CIR) in newly diagnosed AML patients, measured from the date of achievement of a remission (CR/CRh/CRi) to date of relapse, or date of start of new (non-study) therapy due to confirmed molecular progression or relapse. Death in remission will be considered as a competing event. Patients who are not known to have relapsed, died or started new therapy due to molecular progression or relapse will be censored at the date of last clinical response assessment., Cumulative incidence of death (CID) in newly diagnosed AML patients, measured from the date of achievement of a remission (CR/CRh/CRi) to death without prior relapse (may it be morphologic relapse or confirmed molecular progression or relapse with subsequent start of new non-study therapy). Relapse after achieving CR/CRh/CRi or start of new therapy due to confirmed molecular progression or relapse will be considered as a competing event., Quality of life among AML patients as assessed by o EQ-5D-5L visual analogue scale (VAS) among AML patients o EORTC-QLQ-C30 global health status/QoL scale and QLQ-C30 subdomains and o PROMIS Cancer Fatigue short form, version 7a., Event-free survival in newly diagnosed AML patients, defined as the time from randomization to treatment failure, death from any cause, relapse after achieving CR, CRh or CRi, or start of new (non-study) therapy due to confirmed molecular progression or relapse whichever occurs first. Treatment failure is defined as not attaining CR, CRh or CRi by induction chemotherapy, i.e. if a patient’s best response during or at completion of the induction treatment is less than CR/CRh/CRi., Rate of complete remission (CR) or CR with partial hematologic recovery (CRh) in newly diagnosed AML patients defined as the proportion of AML patients with CR/CRh by the end of induction chemotherapy.

Source: https://euclinicaltrials.eu/ctis-public/view/2023-507518-28-00